EU clinical trial 2025-521875-30-00: An open-label, phase 2 study, evaluating the efficacy of treatment with Gilteritinib in measurable residual disease eradication in patients with FLT3-ITD mutated acute myeloid leukemia
Protocol code: ISR007028
Sponsor: Hellenic Society Of Hematology (Patient organisation/association). Phase: Therapeutic exploratory (Phase II). Countries: Greece (ongoing, recruiting).
Therapeutic area(s): Diseases [C] - Neoplasms [C04]
Gender: Female, Male. Age: 18-64 years, 65+ years. Enrolment: 58.
Status: Ongoing, recruiting. Start date (EU): 2026-05-28. Decision date: 2025-11-20. Results received: No. Last updated: 2025-11-20.

Condition(s): Acute myeloid leukaemia, Acute myeloid leukaemia
Product: Xospata 40 mg film-coated tablets

Primary endpoint: The rate of FLT3-ITD MRD negativity after 2 cycles of treatment with Gilteritinib.
Endpoint(s): Frequency and type of resistance mutations detected at relapse, with particular emphasis on the, RAS/MAPK pathway ( such as NRAS, KRAS, PTPN11, CBL, NF1)., Time to development of resistance (e.g., median duration of treatment before resistance is observed)., Phenotypic changes (via flow cytometry) associated with resistance. More specifically, phenotypes such as the CD34+CD38-CD123+ or the CD47, TIM-3, CD96 expression and the appearence/re-appearence of antigenic characterists will be evaluated., Baseline biomarker profiles (gene expression, mutation profile, proteomics) correlated with treatment response. More specifically, the presence of co-mutations in DNMT3A, NPM1, TET2, ASXL1, TP53 and the expression of antiapoptotic genes (such as the BCL2 and the MCL1) will be evaluated., Correlation between immune microenvironment features and response to treatment. More specifically, the expression of immunoregulatory molecules, such as the PD-L1, LAG-3, TIM-3 and the percentage of CD8+, T-regulatory and NK cells will be evaluated., Predictive value of specific genomic or transcriptomic signatures for MRD negativity.

Source: https://euclinicaltrials.eu/ctis-public/view/2025-521875-30-00